EU clinical trial 2025-521140-38-00: A randomized, three-period, single-dose crossover trial in healthy female volunteers to demonstrate bioequivalence of tafoxiparin following subcutaneous administration via syringe/needle in the abdomen, and via an auto-injector in the abdomen and thigh, respectively.
Protocol code: PPL24
Sponsor: Dilafor AB (Pharmaceutical company). Phase: Human Pharmacology (Phase I)- Bioequivalence Study. Countries: Sweden (ended).
Therapeutic area(s): Diseases [C] - Female Urogenital Diseases and Pregnancy Complications [C13]
Gender: Female. Age: 18-64 years. Enrolment: 24.
Status: Ended. Start date (EU): 2026-02-11. End date (EU): 2026-03-27. Decision date: 2025-06-09. Results received: No. Last updated: 2025-06-09.

Condition(s): Labor priming

Source: https://euclinicaltrials.eu/ctis-public/view/2025-521140-38-00